EU clinical trial 2025-523599-21-00: A Master Protocol of a Phase II, Open-label, Multicenter, Global Platform Study to Evaluate the Safety and Efficacy of Immunotherapy With or Without Other Anticancer Drugs in Participants with Unresectable Stage III Non-small Cell Lung Cancer Planning to Undergo Concurrent Chemoradiotherapy (AQUARIUS)
Protocol code: D702PC00001
Sponsor: AstraZeneca AB (Pharmaceutical company). Phase: Therapeutic exploratory (Phase II). Countries: Spain (authorised, recruitment pending), Germany (authorised, recruitment pending).
Therapeutic area(s): Diseases [C] - Neoplasms [C04]
Gender: Female, Male. Age: 18-64 years, 65+ years. Enrolment: 11.
Status: Authorised, recruitment pending. Decision date: 2026-06-29. Results received: No. Last updated: 2026-06-30.
Decision dates by country: DE: 2026-06-29, ES: 2026-06-30

Condition(s): Non-small Cell Lung Cancer
Product: PEMETREXED, CARBOPLATIN, Rilvegostomig, PACLITAXEL, MYCOPHENOLATE MOFETIL, CISPLATIN, INFLIXIMAB

Primary endpoint: The safety and tolerability of immunotherapy with or without other anticancer drugs in participants with unresectable Stage III NSCLC will be assessed.
Endpoint(s): PFS is defined as time from the date of treatment assignment/randomization or Cycle 1 Day 1 (as applicable, depending on the design of the relevant substudy) until radiological progression per RECIST 1.1 or death due to any cause (in the absence of progression)., ORR is defined as the proportion of participants who have a CR or PR, "XXX" per RECIST 1.1 for induction therapy or overall., Concentration of immunotherapy in serum., Presence of anti-drug antibodies (ADAs), positive or negative and titers

Source: https://euclinicaltrials.eu/ctis-public/view/2025-523599-21-00